EU clinical trial 2024-515098-93-00: A Multi-phase, Dose-Escalation followed by an Open-label, Randomized, Crossover Study of Oral ASTX030 (Cedazuridine and Azacitidine Given in Combination) Versus Subcutaneous Azacitidine in Subjects with Myelodysplastic Syndromes (MDS), Chronic Myelomonocytic Leukemia (CMML), or Acute Myeloid Leukemia (AML)
Protocol code: ASTX030-01
Sponsor: Taiho Oncology Inc. (Pharmaceutical company). Phase: Therapeutic confirmatory (Phase III). Countries: Italy (authorised, recruiting), Hungary (ongoing, recruiting), Spain (ongoing, recruiting), Czechia (ongoing, recruiting), Germany (ongoing, recruiting), Poland (ongoing, recruiting), France (ongoing, recruiting).
Therapeutic area(s): Diseases [C] - Hemic and Lymphatic Diseases [C15]
Gender: Female, Male. Age: 18-64 years, 65+ years. Enrolment: 588.
Start date (EU): 2025-07-22. Decision date: 2025-05-30. Results received: No. Last updated: 2026-05-27.
Decision dates by country: DE: 2025-06-02, CZ: 2025-05-30, FR: 2025-06-24, HU: 2025-05-30, ES: 2025-06-03, IT: 2025-06-03, PL: 2025-06-03

Condition(s): Myelodysplastic Syndromes (MDS), Chronic Myelomonocytic Leukemia (CMML)
Product: Azacitidine, Cedazuridine, Azacitidine, Vidaza 25 mg/ml powder for suspension for injection, Azacitidine, Cedazuridine

Primary endpoint: • Ratio of azacitidine total cycle AUC 0-24 exposures after oral ASTX030 over SC azacitidine at 75 mg/m2/day
Endpoint(s): 1 TEAEs including SAEs, 2 Percent LINE-1 demethylation change from baseline between SC azacitidine and ASTX030 in Cycles 1 and 2, 3 Participants with MDS or CMML: - Clinical response rate - AML-free survival - Duration of response - OS - Time to response - Transfusion independence

Source: https://euclinicaltrials.eu/ctis-public/view/2024-515098-93-00